EU clinical trial 2024-520229-35-00: A clinical study of MK-5661 in healthy people (MK-5661-007)
Protocol code: MK-5661-007
Sponsor: Merck Sharp & Dohme LLC (Pharmaceutical company). Phase: Human Pharmacology (Phase I)- Other. Countries: Belgium (authorised, recruitment pending).
Therapeutic area(s): Diseases [C] - Nervous System Diseases [C10]
Gender: Female, Male. Age: 18-64 years. Enrolment: 16.
Status: Authorised, recruitment pending. Decision date: 2025-05-23. Results received: No. Last updated: 2025-09-02.

Condition(s): Pain

Source: https://euclinicaltrials.eu/ctis-public/view/2024-520229-35-00